EU clinical trial 2025-522839-33-00: The "MAGNEFFICIENT" Prospective Trial: Preoperative Administration of MAGNesium for EFFICIENT Parathyroids after Thyroidectomy
Protocol code: MAGNEFFICIENT
Sponsor: Henry Dunant Hospital Center (Hospital/Clinic/Other health care facility). Phase: Therapeutic confirmatory (Phase III). Countries: Greece (authorised, recruitment pending).
Therapeutic area(s): Diseases [C] - Hormonal diseases [C19]; Analytical, Diagnostic and Therapeutic Techniques and Equipment [E] - Therapeutics [E02]; Analytical,Diagnostic,Therapeutic Techniques and Equipment [E]-Surgical Procedures, Operative [E04]
Gender: Female, Male. Age: 18-64 years, 65+ years. Enrolment: 500.
Status: Authorised, recruitment pending. Decision date: 2025-10-22. Results received: No. Last updated: 2025-10-22.

Condition(s): Postoperative Hypoparathyroidism after thyroid surgery.
Product: The placebo has the same composition as the investigational medicinal product t r o f o c a r d ® m a x granules for oral solution 2.459,2 (243mg++) mg/sachet (with the exception of the active substance), is manufactured by the same manufacturer (uni-pharma kleon tsetis pharmaceutical laboratory s.a) and is not sterile., TROFOCARD® max

Primary endpoint: Incidence of chronic postoperative hypoparathyroidism at 6 months post-surgery, defined by persistently low corrected calcium and PTH values in the absence of vitamin D or calcium discontinuation.
Endpoint(s): Incidence of temporary hypoparathyroidism at 30 days., Differences in replacement therapy needs (alfacalcidol, calcium carbonate, cholecalciferol) at Day 7, Month 1, 3, and 6., Safety/tolerability based on AE/SAE reports., Patient-reported symptoms of hypocalcemia.

Source: https://euclinicaltrials.eu/ctis-public/view/2025-522839-33-00